EU clinical trial 2025-524598-17-00: A randomized, placebo controlled, observer-blind, phase IV pragmatic trial to evaluate the effect of Recombinant Zoster Vaccine (Shingrix®) on incident dementia diagnosis in an older adult population aged ≥76 years in Finland
Protocol code: 300889
Sponsor: GlaxoSmithKline Biologicals (Pharmaceutical company). Phase: Therapeutic use (Phase IV). Countries: Finland (ongoing, recruiting).
Therapeutic area(s): Diseases [C] - Nervous System Diseases [C10]
Gender: Female, Male. Age: 65+ years. Enrolment: 35000.
Status: Ongoing, recruiting. Start date (EU): 2026-03-31. Decision date: 2026-02-16. Results received: No. Last updated: 2026-07-08.

Condition(s): Incident dementia
Product: The Placebo used for the clinical trial is a sterile saline solution (0.9% w/v solution of NaCl in water) supplied in 1.25 mL pre-filled glass syringes., Shingrix powder and suspension for suspension for injection Herpes zoster vaccine (recombinant, adjuvanted), Shingrix suspension for injection in pre filled syringe Herpes zoster vaccine (recombinant, adjuvanted)

Primary endpoint: 1. Incident diagnosis of dementia post-first dose of Shingrix or placebo.
Endpoint(s): 1. Incident diagnosis of dementia occurring 1 month post-second dose of Shingrix or placebo., 2. Incident diagnosis of AD post-first dose of Shingrix or placebo.

Source: https://euclinicaltrials.eu/ctis-public/view/2025-524598-17-00